EU clinical trial 2024-515778-28-00: 18-month double-blind, randomized, placebo-controlled, multicenter, Phase 3 study to evaluate the safety and efficacy of oral nizubaglustat (AZ-3102) in late-infantile and juvenile forms of Niemann-Pick type C disease and in late-infantile and juvenile-onset forms of GM1 gangliosidosis or GM2 gangliosidosis
Protocol code: AZA-001-301
Sponsor: Azafaros B.V. (Pharmaceutical company). Phase: Therapeutic confirmatory (Phase III). Countries: France (ongoing, recruiting), Portugal (ongoing, recruiting), Germany (ongoing, recruiting), Italy (ongoing, recruiting), Spain (ongoing, recruiting), Sweden (ongoing, recruiting).
Therapeutic area(s): Diseases [C] - Congenital, Hereditary, and Neonatal Diseases and Abnormalities [C16]
Gender: Female, Male. Age: 0-17 years, 18-64 years. Enrolment: 54.
Status: Ongoing, recruiting. Start date (EU): 2025-06-30. Decision date: 2024-12-18. Results received: No. Last updated: 2026-05-26.
Decision dates by country: SE: 2024-12-20, FR: 2024-12-18, ES: 2024-12-19, DE: 2024-12-20, PT: 2024-12-20, IT: 2025-01-08

Condition(s): Niemann-Pick type C disease and GM1/GM2 gangliosidoses
Product: Nizubaglustat, Microcrystalline Cellulose (Avicel PH-102), Nizubaglustat

Primary endpoint: Change from Baseline to Week 72 in cale for Assessment and Rating of Ataxia (SARA) score, using both total SARA and functional SARA.
Endpoint(s): 1. Change from Baseline to Weeks 24, 48, and 72 in: • SARAGAIT/POSTURE • SARASPEECH • SARAKINETICS • Vineland Adaptative Behavior Scale (VABS) comprehensive interview form • Penetration-Aspiration Scale (PAS), 2. Change from Baseline to Weeks 24, 48, and 72 in: • 9-Hole Peg Test (9-HPT-D): change in time taken to complete the test using the dominant hand • Goal attainment scale (GAS) • Clinical global impression of change (CGI-C) • Participant/caregiver global impression of change (PGI-C) • Seizure frequency and duration, as per the seizure diary, Cont.Translation- Portuguese and French, 3. Time-to-event comparison between nizubaglustat and placebo over the study duration for pre-defined detrimental events of: • An increase in total SARA score of ≥2 points and/or an increase in functional SARA of ≥1.5 points • A decrease in PAS of ≥1 point • Participants leaving the study due to participant/caregiver perception of disease progression/lack of efficacy., 4. For subprotocol AZA-001-301-NPC only, change from Baseline in NPC Clinical Severity Scale (NPC-CSS) score, 5. The concentrations of nizubaglustat and its metabolites in plasma. The main PK parameters assessed will be: •Maximum observed plasma concentration (Cmax) and time to Cmax (Tmax) • Plasma trough concentration (Ctrough) at Week 4 • Area under the plasma concentration-time curve from the time of dosing (zero) to 24 hours post-dose (AUC0-24) at Baseline • Accumulation ratio for Cmax., 6. Change from Baseline to Weeks 4, 24, 48 and 72 in the plasma GlcCer C16:0; C18:0 concentration., 15. Incidence and severity of treatment-emergent adverse events (TEAEs). Change in vital sign parameters, electrocardiogram (ECG) parameters, and laboratory safety parameters from Baseline to each study visit. Incidence of treatment-emergent abnormal laboratory values and ECG abnormalities.

Source: https://euclinicaltrials.eu/ctis-public/view/2024-515778-28-00